EU clinical trial 2023-507527-28-00: Assessing the Safety, Immune Response, and Early Efficacy of a Candida Vaccine in Women with Recurrent Vulvovaginal Candidiasis: A Randomized Controlled Study
Protocol code: Candi5V01
Sponsor: LimmaTech Biologics AG (Pharmaceutical company). Phase: Phase I and Phase II (Integrated)- First administration to humans. Countries: Belgium (ongoing, recruitment ended), Poland (ongoing, recruitment ended).
Therapeutic area(s): Diseases [C] - Bacterial Infections and Mycoses [C01]
Gender: Female. Age: 18-64 years. Enrolment: 251.
Status: Ongoing, recruitment ended. Start date (EU): 2024-09-16. Decision date: 2023-11-21. Results received: No. Last updated: 2026-04-28.
Decision dates by country: BE: 2023-11-21, PL: 2023-11-30

Condition(s): Recurrent vulvovaginal candidiasis

Source: https://euclinicaltrials.eu/ctis-public/view/2023-507527-28-00